EU clinical trial 2024-518613-26-01: A Study to Learn How Safe Different Doses of NTS-521 are, What the Amount of NTS-521 in the Body is Over a Period of Time, and What the Effects of NTS-521 on the Body and the Body on NTS-521 are in Adult and Elderly People Receiving Single and Multiple Doses of NTS-521 via an Infusion Directly into a Vein
Protocol code: NTS-521-A001-101
Sponsor: Neurotrauma Sciences LLC (Pharmaceutical company). Phase: Human Pharmacology (Phase I)- First administration to humans. Countries: Belgium (ended).
Therapeutic area(s): Diseases [C] - Nervous System Diseases [C10]
Gender: Female, Male. Age: 18-64 years, 65+ years. Enrolment: 120.
Status: Ended. Start date (EU): 2025-06-06. End date (EU): 2026-04-07. Decision date: 2025-04-30. Results received: No. Last updated: 2025-11-26.

Source: https://euclinicaltrials.eu/ctis-public/view/2024-518613-26-01